EU clinical trial 2024-510816-55-00: Safety and Efficacy of Recombinant Interferon-Gamma 1b (rIFN-Gamma 1b) Given With Standard Therapy in Patients With Candidemia
Protocol code: 109864
Sponsor: Stichting Radboud University Medical Center (Patient organisation/association). Phase: Therapeutic exploratory (Phase II). Countries: Netherlands (ended), Greece (ended), Romania (ended), Germany (ended).
Therapeutic area(s): Diseases [C] - Bacterial Infections and Mycoses [C01]
Gender: Female, Male. Age: 18-64 years, 65+ years. Enrolment: 125.
Status: Ended. Start date (EU): 2024-11-08. End date (EU): 2026-03-30. Decision date: 2024-11-08. Results received: No. Last updated: 2025-04-02.
Decision dates by country: DE: 2024-11-11, GR: 2025-01-23, RO: 2024-11-27, NL: 2024-11-08

Condition(s): Candidemia
Product: IMMUKINE, oplossing voor injectie 2 x 10^6 IE (0,1 mg)

Primary endpoint: Time to first negative blood culture.
Endpoint(s): Time of resolution to infection (composite endpoint)., Percentage of patients with mycological outcomes at EOST, EOT, and day 14 and day 28 after EOT., Percentage of patients with treatment success at EOST, EOT, and day 14 and day 28 after EOT., Overall survival at Study Day 28., Number of patients with Treatment Emergent Adverse Events (TEAEs)., Evaluation of patient status at end of rIFN-γ treatment including organ (dys)function (Sequential Organ Failure Assessment [SOFA] score), and adverse events, Nutritional status (body weight, BMI), nutritional blood parameters (prealbumin, total lymphocytes, cholesterol)., Genetics and transcriptomics., Gut microbiota composition and Candida genomics and metabolomics, Changes in circulating cytokines, biomarkers, LAP activation, inflammasome, and immunoprofiling.

Source: https://euclinicaltrials.eu/ctis-public/view/2024-510816-55-00